EU clinical trial 2023-504135-40-00: A Phase 3, Parallel-group Treatment, Blinded, Randomized, Placebo-controlled Study to Assess the Efficacy and Safety of Pegtibatinase Administered Subcutaneously in Addition to Standard of Care in Participants with Classical Homocystinuria due to Cystathionine Beta Synthase Deficiency (HARMONY)
Protocol code: TVTX-TVT058-301
Sponsor: Travere Therapeutics Inc. (Pharmaceutical company). Phase: Therapeutic confirmatory (Phase III). Countries: Belgium (authorised, recruitment pending), Ireland (authorised, recruitment pending), Spain (authorised, recruitment pending), Italy (authorised, recruitment pending), Germany (authorised, recruitment pending), France (authorised, recruitment pending), Portugal (authorised, recruitment pending), Poland (authorised, recruitment pending).
Therapeutic area(s): Diseases [C] - Nutritional and Metabolic Diseases [C18]
Gender: Female, Male. Age: 0-17 years, 18-64 years, 65+ years. Enrolment: 22.
Status: Authorised, recruitment pending. Decision date: 2026-04-27. Results received: No. Last updated: 2026-08-07.
Decision dates by country: ES: 2026-05-04, DE: 2026-05-04, FR: 2026-04-27, IE: 2026-05-01, PT: 2026-04-30, PL: 2026-04-30, BE: 2026-04-29, IT: 2026-04-28

Condition(s): Classical Homocystinuria
Product: Pegtibatinase, 0.9 % sodium chloride saline solution (NaCL)

Primary endpoint: The change from baseline averaged over Week -3, Week -1, and Day 1 pre-dose in plasma tHcy levels averaged over Weeks 6 through 12 (6, 8, 10, and 12) in participants receiving standard of care and treated with pegtibatinase as compared to placebo
Endpoint(s): The change from baseline in plasma tHcy levels averaged post Week 12 (Weeks 16, 20, and 24) in participants receiving standard of care and treated with pegtibatinase as compared to placebo, The change from baseline in plasma Met levels averaged over Weeks 6 through 12 in participants receiving standard of care and treated with pegtibatinase as compared to placebo, The change from baseline in plasma Met levels averaged post Week 12 in participants receiving standard of care and treated with pegtibatinase as compared to placebo, The proportion of participants achieving tHcy <100 µM averaged over Weeks 6 through 12, among participants with tHcy ≥100 µM at baseline, The proportion of participants achieving tHcy <100 µM averaged post Week 12 among participants with tHcy ≥100 µM at baseline, The proportion of participants with tHcy <50 µM averaged over Weeks 6 through 12, The proportion of participants with tHcy <50 µM averaged post Week 12, The proportion of participants achieving tHcy reduction ≥35% from baseline averaged over Weeks 6 through 12, and averaged post Week 12, The proportion of participants achieving tHcy <100 µM and a ≥35% reduction from baseline averaged over Weeks 6 through 12, and averaged post Week 12 among participants with tHcy ≥100 µM at baseline, The proportion of participants with tHcy ≤15 µM averaged over Weeks 6 through 12, and averaged post Week 12

Source: https://euclinicaltrials.eu/ctis-public/view/2023-504135-40-00